EU clinical trial 2023-507049-28-00: First-In-Human, Open-Label, Dose Escalation Trial with Expansion Cohorts to Evaluate the Safety and Preliminary Efficacy of GEN1055 as Monotherapy and as Combination Therapy in Subjects with Malignant Solid Tumors.
Protocol code: GCT1055-01
Sponsor: Genmab A/S (Pharmaceutical company). Phase: Phase I and Phase II (Integrated)- First administration to humans. Countries: Spain (ended).
Therapeutic area(s): Diseases [C] - Neoplasms [C04]
Gender: Female, Male. Age: 18-64 years, 65+ years. Enrolment: 45.
Status: Ended. Start date (EU): 2024-04-16. End date (EU): 2025-11-20. End date: 2025-11-20. Decision date: 2024-03-15. Results received: No. Last updated: 2025-04-09.

Condition(s): Malignant Solid Tumors
Product: PEMETREXED DISODIUM, PEMBROLIZUMAB, PEMBROLIZUMAB, PACLITAXEL, GEN1055 DP, CISPLATIN, GEMCITABINE, PACLITAXEL ALBUMIN-BOUND, CARBOPLATIN

Primary endpoint: Dose Escalation Phase 1a and 1b: Incidence and severity of AEs, Dose Escalation Phase 1a and 1b: Incidence of DLTs, Expansion: According to RECIST v1.1 as assessed by investigator: ORR
Endpoint(s): Dose Escalation Phase 1a and 1b: PK parameters for GEN1055: • Cmax • tmax • Ctrough • AUC0-tlast • AUC0-inf • t½ • CL, Dose Escalation Phase 1a and 1b: ADA response to GEN1055 as monotherapy and as combination therapy with pembrolizumab, Dose Escalation Phase 1a and 1b: According to RECIST v1.1 as assessed by investigator: • ORR • DoR • TTR • DCR, Expansion: According to RECIST v1.1 as assessed by investigator: • DoR • TTR • DCR, Expansion: • PFS according to RECIST v1.1 as assessed by investigator • OS, Expansion: Incidence and severity of AEs, Expansion: ADA response to GEN1055 as monotherapy and as combination therapy, Expansion: PK parameters for GEN1055: • Cmax • tmax • Ctrough • AUC0-tlast • AUC0-inf • t½ • CL

Source: https://euclinicaltrials.eu/ctis-public/view/2023-507049-28-00